EU clinical trial 2023-504958-35-00: Imatinib PD in healthy subjects
Protocol code: CHDR2318
Sponsor: Centre for Human Drug Research (Laboratory/Research/Testing facility). Phase: Human Pharmacology (Phase I)- Other. Countries: Netherlands (ended).
Therapeutic area(s): Not possible to specify
Gender: Female, Male. Age: 18-64 years. Enrolment: 36.
Status: Ended. Start date (EU): 2023-12-13. End date (EU): 2026-04-09. Decision date: 2023-12-08. Results received: No. Last updated: 2025-06-02.

Condition(s): Immuno-oncology assessments

Source: https://euclinicaltrials.eu/ctis-public/view/2023-504958-35-00